EU clinical trial 2024-518617-25-00: A Phase II, Open-Label, multicentre, study investigating tolerability and efficacy of Gilteritinib in combination with fludarabine, cytarabine and idarubicin (FLAI) as induction therapy of newly diagnosed non-M3 FLT3-positive acute myeloid leukemia.GIMEMA AML2924
Sponsor: Fondazione Gimema Franco Mandelli Onlus (Patient organisation/association). Phase: Therapeutic exploratory (Phase II). Countries: Italy (authorised, recruitment pending).
Therapeutic area(s): Diseases [C] - Hemic and Lymphatic Diseases [C15]
Gender: Female, Male. Age: 18-64 years. Enrolment: 80.
Status: Authorised, recruitment pending. Decision date: 2025-07-04. Results received: No. Last updated: 2026-02-10.

Condition(s): newly diagnosed non-M3 FLT3-positive acute myeloid leukemia
Product: Xospata 40 mg film-coated tablets

Primary endpoint: Primary end point is the rate of CR after course 1 or course 2 if course 2 is administered (CR + CRi + CRp).
Endpoint(s): Percentage of MRD negative CR (flow cytometry) after cycle 1, 2, consolidation, End of Treatment and follow-up (centralized analysis)., To Describe duration of MRD negative CR measured as the time from achievement of MRD negative CR to MRD positive test, relapse or death for any cause., To Describe PFS, measured as the time from 1st day of administration of study treatment to progression or death for any cause., To Describe OS, measured as the time from 1st day of administration of study treatment to death for any cause., To Describe the proportion of patients who proceed to HSCT in MRD negative CR., To Describe the incidence of AE., To Analyze incidence and type of whole gene FLT3 mutations., To Analyze the overlap between conventional MRD and MRD with next generation technologies (NGS) for correlative purposes., To Describe adherence to treatment., To Describe quality of life.

Source: https://euclinicaltrials.eu/ctis-public/view/2024-518617-25-00